EU clinical trial 2024-518219-20-00: DonneDVit : Assessing the Impact of a Mode of Vitamin D Supplementation (Sequential Dose vs Daily Dose) on the Incidence of Hypercalciuria in Subjets Aged From 2 to 18 Years. Randomized controlled trial with 2 parallel groups.
Protocol code: 15_0500
Sponsor: Centre Hospitalier Universitaire De Montpellier (Hospital/Clinic/Other health care facility). Phase: Therapeutic use (Phase IV). Countries: France (authorised, recruitment pending).
Therapeutic area(s): Phenomena and Processes [G] - Reproductive and Urinary Physiological Phenomena [G08]
Gender: Female, Male. Age: 0-17 years, 18-64 years. Enrolment: 280.
Status: Authorised, recruitment pending. Decision date: 2024-11-15. Results received: No. Last updated: 2025-02-28.

Condition(s): Transient hypercalciuria
Product: ADRIGYL 10 000 UI/ml, solution buvable en gouttes, UVEDOSE 100 000 UI, solution buvable en ampoule

Primary endpoint: Occurrence of hypercalciuria beyond the lithogenic threshold for age. This will be assessed by measuring the calcium/creatinine ratio in mmol/mmol in the first morning urine sample collected during at least one of the three measurements taken on day 7, day 14, and day 28.
Endpoint(s): Detection of calcium oxalate microcrystals in the first morning urine sample during at least one of the three crystalluria analyses conducted on day 7, day 14, and day 28., Evaluation of tolerance: systematic collection of expected and unexpected adverse events.

Source: https://euclinicaltrials.eu/ctis-public/view/2024-518219-20-00